EU clinical trial 2023-506414-46-00: A Prospective, Open-Label, Multicenter, Randomized, Phase 3 Trial of Acalabrutinib, Obinutuzumab and Venetoclax (GAVe) Compared to Obinutuzumab and Venetoclax (GVe) in Previously Untreated Patients with High Risk Chronic Lymphocytic Leukemia (CLL): The CLL16-TRIAL OF THE GCLLSG
Protocol code: CLL16
Sponsor: University Of Cologne (Educational Institution). Phase: Therapeutic confirmatory (Phase III). Countries: Germany (ongoing, recruiting), Austria (ongoing, recruiting), Portugal (ongoing, recruiting).
Therapeutic area(s): Diseases [C] - Hemic and Lymphatic Diseases [C15]
Gender: Female, Male. Age: 18-64 years, 65+ years. Enrolment: 232.
Status: Ongoing, recruiting. Start date (EU): 2022-04-22. Decision date: 2024-08-22. Results received: No. Last updated: 2026-06-10.
Decision dates by country: PT: 2026-02-12, DE: 2024-08-22, AT: 2024-08-26

Condition(s): High risk patients defined as having at least one of the following risk factors: 17p-deletion, TP53-mutation or complex karyotype (defined as defined as the presence of 3 or more chromosomal aberrations in 2 or more metaphases), or an unmutated IGHV status
Product: OBINUTUZUMAB, VENETOCLAX, ACALABRUTINIB, ACALABRUTINIB, VENETOCLAX, VENETOCLAX

Primary endpoint: The primary endpoint of the study is investigator assessed progression-free survival (PFS). The study is designed to demonstrate that treatment with GAVe prolong PFS as compared to treatment with GVe in patients with high risk CLL (defined as having at least one of the following risk factors: 17p-deletion, TP53- mutation, or complex karyotype, and/or unmutated IGHV-status).
Endpoint(s): Measurable residual disease (MRD) levels in the peripheral blood (PB) and in the bone marrow (BM) at final restaging (Staging 5, cycle 15 day 1 for patients in GVe study arm, cycle 14 day 14 for patients in GAVe study arm), MRD in PB at cycle 27 day 1 for all patients (Staging 9, respectively end of maintenance for patients in GAVe study arm, who had detectable MRD levels after 14 cycles of GAVe-treatment), Overall response rate (ORR; as per iwCLL guidelines) at cycle 15, Complete response rate (CRR; as per iwCLL guidelines) at cycle 15, Overall Survival (OS), Event-free survival (EFS), Duration of response (DOR), Time to next treatment (TTNT)

Source: https://euclinicaltrials.eu/ctis-public/view/2023-506414-46-00